EU clinical trial 2023-508868-30-00: AN OPEN-LABEL, MULTICENTER, OUTPATIENT EXTENSION STUDY TO EVALUATE THE SAFETY AND TOLERABILITY OF STACCATO ALPRAZOLAM IN STUDY PARTICIPANTS 12 YEARS OF AGE AND OLDER WITH STEREOTYPICAL PROLONGED SEIZURES
Protocol code: EP0165
Sponsor: UCB Biopharma (Pharmaceutical company). Phase: Therapeutic confirmatory (Phase III). Countries: Poland (ongoing, recruiting), Hungary (ongoing, recruiting), Czechia (ongoing, recruiting), Spain (ongoing, recruiting), Germany (ongoing, recruiting), Bulgaria (ongoing, recruiting), Italy (ongoing, recruiting).
Therapeutic area(s): Diseases [C] - Nervous System Diseases [C10]
Gender: Female, Male. Age: 0-17 years, 18-64 years, 65+ years. Enrolment: 111.
Status: Ongoing, recruiting. Start date (EU): 2022-09-26. Decision date: 2024-06-07. Results received: No. Last updated: 2026-08-05.
Decision dates by country: PL: 2024-06-10, DE: 2024-06-07, HU: 2024-06-07, BG: 2024-07-01, CZ: 2024-06-11, IT: 2024-06-26, ES: 2024-06-07

Condition(s): Treatment of stereotypical prolonged seizure
Product: alprazolam, Placebo matching Staccato® alprazolam and without active substance

Primary endpoint: 1. Frequency of treatment-emergent adverse events (TEAEs) 2. Frequency of TEAEs leading to withdrawal from study 3. Frequency of serious TEAEs
Endpoint(s): 1. Treatment success after investigational medicinal product (IMP) administration for seizures occurring within the first 12 months 2. Treatment success after IMP administration with no recurrence after 2 hours for seizures occurring within first 12 months 3. Frequency of respiratory TEAEs

Source: https://euclinicaltrials.eu/ctis-public/view/2023-508868-30-00